EU clinical trial 2023-507685-10-00: A Phase 3, Randomized, Open-label, Multi-center Study Evaluating the Efficacy and Safety of TAR-200 Versus Investigator’s Choice of Intravesical Chemotherapy in Participants Who Received Bacillus Calmette-Guérin (BCG) and Recurred with High-risk Non-muscle-invasive Bladder Cancer (HR-NMIBC) and Who Are Ineligible for or Elected Not to Undergo Radical Cystectomy
Protocol code: 17000139BLC3004
Sponsor: Janssen Cilag International (Pharmaceutical company). Phase: Therapeutic confirmatory (Phase III). Countries: Germany (ongoing, recruitment ended), Romania (ongoing, recruitment ended), Belgium (ongoing, recruitment ended), Italy (ongoing, recruitment ended), Poland (ongoing, recruitment ended), France (ongoing, recruitment ended), Spain (ongoing, recruitment ended).
Therapeutic area(s): Diseases [C] - Neoplasms [C04]
Gender: Female, Male. Age: 18-64 years, 65+ years. Enrolment: 102.
Status: Ongoing, recruitment ended. Start date (EU): 2024-05-30. Decision date: 2024-05-13. Results received: No. Last updated: 2026-08-06.
Decision dates by country: RO: 2024-06-06, IT: 2024-05-20, FR: 2024-05-17, PL: 2024-05-20, DE: 2024-05-16, BE: 2024-05-21, ES: 2024-05-13

Condition(s): High-Risk Non-muscle-invasive Bladder Cancer
Product: GEMCITABINE, JNJ-17000139, MITOMYCIN

Primary endpoint: DFS will be measured as the time from randomization to the time of the first recurrence of HR-NMIBC (HG Ta, any T1 or CIS), progression, or death due to any cause, whichever occurs first. Recurrence or progression of DFS events will be determined by central disease assessments of urine cytology, bladder biopsy, or imaging, as applicable.

Source: https://euclinicaltrials.eu/ctis-public/view/2023-507685-10-00